EU clinical trial 2024-513953-64-00: Phase II Study of Fedratinib and Nivolumab Combination in Patients with Myelofibrosis and Resistance or Suboptimal Response to JAK-inhibitor Treatment - The FRACTION Trial
Protocol code: FRACTION_2021
Sponsor: Frankfurter Institut Fuer Klinische Krebsforschung IKF GmbH (Pharmaceutical company). Phase: Therapeutic exploratory (Phase II). Countries: Germany (ended).
Therapeutic area(s): Diseases [C] - Pathological Conditions, Signs and Symptoms [C23]
Gender: Female, Male. Age: 18-64 years, 65+ years. Enrolment: 30.
Status: Ended. Start date (EU): 2022-06-23. End date (EU): 2026-01-15. Decision date: 2024-10-24. Results received: No. Last updated: 2025-05-06.

Condition(s): Primary and secondary Myelofibrosis
Product: OPDIVO 10 mg/mL concentrate for solution for infusion., Inrebic 100 mg hard capsules

Primary endpoint: Best response rate within 12 treatment cycles according to the IWG-MRT criteria (including complete remission, CR, partial remission, PR, clinical improvement, CI, stable disease, SD) 1, and red cell transfusion (RCT) independency according to Gale et al.
Endpoint(s): Overall safety profile of Fedratinib and Nivolumab combination characterized by type, frequency, severity (graded using the National Cancer Institute Common Terminology Criteria for Adverse Events [NCI CTCAE]), timing and relatedness of adverse events (AEs) and laboratory abnormalities observed during treatment, as well as cumulative incidence of leukemic transformation., clinical benefit,, progression-free survival, duration of response, overall survival, reduction of disease burden, Quality of life assessed by the Myeloproliferative Neoplasm Symptom Assessment Form (MPN-SAF, MPN10; Appendix VI), change in ECOG performance status (Appendix IV) from study entry to each visit where the variable is measured., Adherence assessed by 8-item Adherence questionnaire., Investigation of immune-cell expansion and immune-cell responses to checkpoint-inhibitor therapy at baseline (before first IMP dosing), after 6 months study treatment, and after 12 months study treatment (or at EOT)., Assessment of disease burden measured as allelic burden of the respective driver mutations (JAK2, CALR, MPL) at baseline (before first IMP dosing), after 6 months study treatment and after 12 months study treatment (or at EOT)., Assessment of clonal diversity and evolution by NGS-sequencing of a defined 32 gene panel at baseline (before first IMP dosing), after 6 months study treatment and after 12 months study treatment (or at EOT)., Assessment of bone marrow fibrosis by central histology (Professor Dombrowski, University Medicine Greifswald) at baseline before first IMP dosing (screening period) and after 12 months study treatment (or at EOT).

Source: https://euclinicaltrials.eu/ctis-public/view/2024-513953-64-00